EU clinical trial 2024-516105-23-01: R-HLH - Efficacy of Ruxolitinib as first line treatment in primary haemophagocytic lymphohistiocytosis (HLH) in children: a Phase 2, multicentre, non-comparative study
Sponsor: Assistance Publique Hopitaux De Paris (Hospital/Clinic/Other health care facility). Phase: Therapeutic exploratory (Phase II). Countries: France (ongoing, recruiting).
Therapeutic area(s): Diseases [C] - Immune System Diseases [C20]
Gender: Female, Male. Age: 0-17 years, 18-64 years. Enrolment: 20.
Status: Ongoing, recruiting. Start date (EU): 2024-11-10. Decision date: 2024-12-16. Results received: No. Last updated: 2024-12-16.

Condition(s): haemophagocytic lymphohistiocytosis (HLH) in children
Product: Jakavi 15 mg tablets, Jakavi 5 mg tablets, Jakavi 10 mg tablets, Jakavi 20 mg tablets

Primary endpoint: Survival until HSCT. All causes of death will be taken into account, whether or not related to the course of the disease.

Source: https://euclinicaltrials.eu/ctis-public/view/2024-516105-23-01